EU clinical trial 2023-508161-32-00: A Phase 2, Proof-of-Concept, Randomized, Double-Masked, Placebo-Controlled Study to Determine the Efficacy and Safety of LASN01 in Patients with Thyroid Eye Disease
Protocol code: LASN01-CL-2201
Sponsor: Lassen Therapeutics 1 Inc. (Pharmaceutical company). Phase: Therapeutic exploratory (Phase II). Countries: Spain (ended), Germany (ended).
Therapeutic area(s): Diseases [C] - Eye Diseases [C11]
Gender: Female, Male. Age: 18-64 years, 65+ years. Enrolment: 11.
Status: Ended. Start date (EU): 2024-03-28. End date (EU): 2025-04-02. End date: 2025-04-22. Decision date: 2024-03-01. Results received: Yes. Last updated: 2025-04-11.
Decision dates by country: DE: 2024-04-18, ES: 2024-03-05

Condition(s): Thyroid Eye Disease
Product: LASN01, Sodium Chloride 0.9% Intravenous Infusion BP, Water for Injections BP.

Primary endpoint: Efficacy: To assess changes in proptosis in the study eye compared to baseline as assessed by Exophthalmometer, Safety: To assess the safety and tolerability of LASN01 compared with placebo in patients with TED as assessed by changes in adverse events, concomitant medications, clinical laboratory evaluations, vital signs, ECGs, and physical examinations
Endpoint(s): Changes in TED-related clinical parameters (proptosis, CAS, lid retraction, lid aperture, lagophthalmos, Von Graefe’s sign, and diplopia) in the study eye compared to baseline, PK parameter assessed by serum LASN01 concentration at specified timepoints for maximum plasma concentration (Cmax), PK parameter assessed by serum LASN01 concentration at specified timepoints for time to peak concentration (Tmax), PK parameter assessed by serum LASN01 concentration at specified timepoints for area under curve (AUC), PK parameter assessed by serum LASN01 concentration at specified timepoints for clearance volume (CL), PK parameter assessed by serum LASN01 concentration at specified timepoints for terminal phase volume (Vz), PK parameter assessed by serum LASN01 concentration at specified timepoints for half-life (t1/2)

Source: https://euclinicaltrials.eu/ctis-public/view/2023-508161-32-00